EU clinical trial 2024-517422-25-00: A Phase 3, Two-part, Randomized, Open-label, Adaptive Study Comparing BMS-986365 versus Investigator’s Choice of Therapy Comprising Either Docetaxel or Second Androgen Receptor Pathway Inhibitor (ARPI), in Participants with Metastatic Castration-resistant Prostate Cancer (mCRPC) - rechARge
Protocol code: CA071-1000
Sponsor: Celgene Corp. (Pharmaceutical company). Phase: Therapeutic confirmatory (Phase III). Countries: Germany (ongoing, recruitment ended), Denmark (ongoing, recruitment ended), Italy (ongoing, recruitment ended), Romania (ongoing, recruitment ended), Ireland (ongoing, recruitment ended), Poland (ongoing, recruitment ended), Czechia (ongoing, recruitment ended), Spain (ongoing, recruitment ended), Sweden (ongoing, recruitment ended), France (ongoing, recruitment ended), Austria (ongoing, recruitment ended), Slovakia (ongoing, recruitment ended).
Therapeutic area(s): Diseases [C] - Neoplasms [C04]
Gender: Male. Age: 18-64 years, 65+ years. Enrolment: 374.
Status: Ongoing, recruitment ended. Start date (EU): 2025-05-22. Decision date: 2025-05-02. Results received: No. Last updated: 2026-05-18.
Decision dates by country: CZ: 2025-05-06, IT: 2025-05-02, FR: 2025-05-06, PL: 2025-05-05, IE: 2025-05-09, DE: 2025-05-02, ES: 2025-05-06, AT: 2025-05-12, SK: 2025-08-11, SE: 2025-05-05, DK: 2025-05-02, RO: 2025-05-12

Condition(s): Metastatic Castration-resistant Prostate Cancer (mCRPC)
Product: PREDNISONE, BMS-986365, ENZALUTAMIDE, ABIRATERONE, DOCETAXEL, PREDNISOLONE, ABIRATERONE, ENZALUTAMIDE

Primary endpoint: rPFS (for radiographic progression-free survival) by BICR (Blinded Independent Central Review). The ability of BMS-986365 to work better than other treatments chosen by the doctors is tested by looking at the rPFS, which shows how long it takes for the disease to get worse by radiographic imaging techniques (like X-rays or scans)
Endpoint(s): OS (Overall Survival) This study will assess if people live longer when they take BMS-986365 compared to other treatments chosen by the doctors. This is what is called "Overall Survival".

Source: https://euclinicaltrials.eu/ctis-public/view/2024-517422-25-00